EU clinical trial 2024-517634-17-01: Tau PET imaging in cognitively normal elderly subjects: A twin approach
Sponsor: Amsterdam UMC Stichting (Patient organisation/association). Phase: Therapeutic exploratory (Phase II). Countries: Netherlands (ongoing, recruiting).
Therapeutic area(s): Diseases [C] - Nervous System Diseases [C10]
Gender: Female, Male. Age: 65+ years. Enrolment: 80.
Status: Ongoing, recruiting. Start date (EU): 2024-12-02. Decision date: 2024-12-02. Results received: No. Last updated: 2024-12-02.

Condition(s): Healthy controls (investigating preclinical Alzheimer's Disease)
Product: Flortaucipir

Primary endpoint: 1. To investigate the effect of amyloid status(positive versus negative) on (longitudinal) [18F]AV‐ 1451 accumulation in cognitively normal individuals. 2. To investigate the contribution of genetic factors and non‐genetic factors to (longitudinal) tau accumulation and its interaction with amyloid accumulation

Source: https://euclinicaltrials.eu/ctis-public/view/2024-517634-17-01